EU clinical trial 2024-518280-35-00: The CanISleepinMS Study: Effect of cannabidiol (CBD) on sleep quality in patients with multiple sclerosis, a series of 15 randomised, placebo-controlled N-of-1 trials
Protocol code: NL83212.091.22
Sponsor: Wageningen Research Stichting (Laboratory/Research/Testing facility). Phase: Therapeutic exploratory (Phase II). Countries: Netherlands (ended).
Therapeutic area(s): Not possible to specify
Gender: Female, Male. Age: 18-64 years, 65+ years. Enrolment: 15.
Status: Ended. Start date (EU): 2024-03-26. End date (EU): 2026-04-28. Decision date: 2025-01-17. Results received: No. Last updated: 2025-01-17.

Condition(s): Insomnia
Product: Investigational placebo, Clinican CBD 10% oil, Run-in placebo

Primary endpoint: Insomnia Severity Index (ISI) questionnaire
Endpoint(s): Diary with sleep-related outcomes (Sleep Onset Latency (SOL), number of awakenings (NA), Wake time After Sleep Onset (WASO), Total Sleep Time (TST), and Sleep Efficiency (SE)), Daily recorded non-sleep outcomes are number of nocturnal voiding and potentially occurring adverse events (AEs)., Neurokeys app, The questionnaires ESS, FSS, and CIS-F

Source: https://euclinicaltrials.eu/ctis-public/view/2024-518280-35-00